EU clinical trial 2024-517090-24-00: A Multinational, Multicenter, Open-label, Phase II/III Clinical Trial to Evaluate the Efficacy and Safety of Oral Paclitaxel (DHP107) Compared to IV Paclitaxel as First-line Therapy in Patients with Recurrent or Metastatic HER2 Negative Breast Cancer
Sponsor: Daehwa Pharmaceutical Co. Ltd. (Pharmaceutical company). Phase: Phase II and Phase III (Integrated). Countries: Hungary (ongoing, recruitment ended).
Therapeutic area(s): Diseases [C] - Neoplasms [C04]
Gender: Female, Male. Age: 18-64 years, 65+ years. Enrolment: 10.
Status: Ongoing, recruitment ended. Start date (EU): 2020-10-09. Decision date: 2024-10-18. Results received: No. Last updated: 2026-01-13.

Condition(s): Recurrent or Metastatic HER2 Negative Breast Cancer
Product: TAXOL 6 mg/ml, concentrato per soluzione per infusione

Primary endpoint: Progression-free survival (PFS)
Endpoint(s): Objective Response Rate (ORR), Overall survival (OS), Time to treatment failure (TTF), Disease Control Rate (DCR), EQ-5D-3L

Source: https://euclinicaltrials.eu/ctis-public/view/2024-517090-24-00